EU clinical trial 2023-504932-16-00: A Randomized Phase 3 Study Evaluating Cystectomy with Perioperative Pembrolizumab and Cystectomy with Perioperative Enfortumab Vedotin and Pembrolizumab versus Cystectomy Alone in Participants who are Cisplatin-Ineligible or Decline Cisplatin with Muscle-Invasive Bladder Cancer (KEYNOTE-905/EV-303)
Protocol code: MK-3475-905
Sponsor: Merck Sharp & Dohme LLC (Pharmaceutical company). Phase: Therapeutic confirmatory (Phase III). Countries: Italy (ongoing, recruitment ended), Denmark (ongoing, recruitment ended), Poland (ongoing, recruitment ended), Ireland (ongoing, recruitment ended), Sweden (ongoing, recruitment ended), France (ongoing, recruitment ended), Germany (ongoing, recruitment ended), Hungary (ongoing, recruitment ended), Belgium (ongoing, recruitment ended), Spain (ongoing, recruitment ended).
Therapeutic area(s): Diseases [C] - Neoplasms [C04]
Gender: Female, Male. Age: 18-64 years, 65+ years. Enrolment: 279.
Status: Ongoing, recruitment ended. Start date (EU): 2019-06-04. Decision date: 2024-02-02. Results received: No. Last updated: 2026-06-19.
Decision dates by country: SE: 2024-04-11, PL: 2024-02-05, ES: 2024-04-10, HU: 2024-02-02, IE: 2024-04-09, DK: 2024-04-15, IT: 2024-04-11, BE: 2024-05-08, FR: 2024-02-02, DE: 2024-02-06

Condition(s): Muscle Invasive Bladder Cancer
Product: ENFORTUMAB VEDOTIN, KEYTRUDA 25 mg/mL concentrate for solution for infusion

Primary endpoint: Event-Free Survival (EFS) between Arm C and Arm B
Endpoint(s): EFS between Arm A and Arm B, Overall Survival (OS) between Arm C and Arm B, Overall Survival (OS) between Arm A and Arm B, Pathological Complete Response (pCR) Rate between Arm C and Arm B, pCR Rate between Arm A and Arm B, Disease-Free Survival (DFS), Pathologic Downstaging (pDS) Rate between Arm A and Arm B, pDS Rate between Arm C and Arm B, Number of Participants Experiencing an Adverse Event (AE), Number of Participants Discontinuing Study Treatment due to an AE, Number of Participants Experiencing Perioperative Complications

Source: https://euclinicaltrials.eu/ctis-public/view/2023-504932-16-00